EU clinical trial 2022-503004-24-00: A Phase 3/3b, Randomized, Observer-blind, Multicenter Clinical Study to Evaluate the Efficacy, Safety and Immunogenicity of Fluad and Fluad Quadrivalent Compared to a Non-adjuvanted Influenza Vaccine in Adults ≥65 Years of Age
Protocol code: V118_24
Sponsor: Seqirus UK Limited (Pharmaceutical company). Phase: Therapeutic confirmatory (Phase III). Countries: Romania (ongoing, recruitment ended), Bulgaria (ongoing, recruitment ended), Finland (ongoing, recruitment ended), Spain (ongoing, recruitment ended), Poland (ongoing, recruitment ended), Netherlands (ongoing, recruitment ended), Belgium (ongoing, recruitment ended), Czechia (ongoing, recruitment ended), Italy (ongoing, recruitment ended), Lithuania (ongoing, recruitment ended).
Therapeutic area(s): Diseases [C] - Virus Diseases [C02]
Gender: Female, Male. Age: 65+ years. Enrolment: 27275.
Status: Ongoing, recruitment ended. Start date (EU): 2023-10-20. Decision date: 2023-09-05. Results received: No. Last updated: 2026-05-19.
Decision dates by country: ES: 2023-09-11, LT: 2023-09-06, RO: 2023-09-11, BE: 2023-09-07, IT: 2023-09-06, FI: 2023-09-07, PL: 2023-09-11, CZ: 2023-09-05, BG: 2023-09-11, NL: 2023-09-05

Condition(s): Influenza virus
Product: Fluad Tetra, suspension for injection in pre-filled syringe Influenza vaccine (surface antigen, inactivated, adjuvanted), Fluad suspension for injection in pre-filled syringe Influenza vaccine (surface antigen, inactivated, adjuvanted), FLUARIX (Influenza Vaccine), Fluarix Tetra suspensión inyectable en jeringa precargada Vacuna antigripal (de virus fraccionados e inactivados)

Primary endpoint: First-occurrence of RT-PCR-confirmed influenza, due to any influenza Type A and/or B virus (regardless of antigenic match), occurring from 14 days after vaccination (ie study day 15) and until the end of influenza season, using the protocol-defined ILI definition.
Endpoint(s): First-occurrence of culture-confirmed influenza, due to influenza Type A and/or B virus antigenically matched to the vaccine strains selected for the seasonal vaccine, occurring from 14 days after vaccination (ie study day 15) and until the end of influenza season, using the protocol-defined ILI definition., First-occurrence of culture-confirmed influenza, due to any influenza Type A and/or B virus (regardless of antigenic match), occurring from 14 days after vaccination and until the end of influenza season, using the protocol-defined ILI definition., First-occurrence of RT-PCR-confirmed influenza, due to any influenza Type A and/or B virus (regardless of antigenic match), occurring from 14 days after vaccination (ie study day 15) and until the end of influenza season, using the modified CDC ILI definition as well as the WHO ILI definition., First-occurrence of culture-confirmed influenza, due to influenza Type A and/or B virus antigenically unmatched to the vaccine strains selected for the seasonal vaccine, occurring from 14 days after vaccination (ie study day 15) and until the end of influenza season, using the protocol-defined ILI definition, The measures for immunogenicity as determined by the serum HI antibody titers for Day 1 and Day 22 for four vaccine homologous influenza strains are as follows for the subjects selected for the immunogenicity subset in each season – reference is made to the study protocol, page 80.., Safety of the study vaccines will be assessed in all subjects in terms of the frequency of reported AEs including: • All AEs reported within 30 minutes after vaccination; • SAEs reported during the entire study period; • AESIs reported during the entire study period; • AEs leading to premature withdrawal from the study during the entire study period., Key Secondary Efficacy Endpoint: First-occurrence of RT-PCR-confirmed influenza, due to any influenza Type A and/or B virus (regardless of antigenic match), occurring from 14 days after vaccination (ie study day 15) and until the end of influenza season, using the protocol-defined ILI definition.

Source: https://euclinicaltrials.eu/ctis-public/view/2022-503004-24-00